EU clinical trial 2025-523676-23-00: The effect of early Landiolol in patients with ST-elevation acute coronary syndrome undergoing primary percutaneous coronary intervention – A prospective, randomized, double- blinded, placebo controlled, phase IV pilot trial (STEMILAND-1)
Sponsor: Medical University Of Vienna (Educational Institution). Phase: Therapeutic use (Phase IV). Countries: Austria (authorised, recruitment pending).
Therapeutic area(s): Diseases [C] - Cardiovascular Diseases [C14]
Gender: Female, Male. Age: 18-64 years, 65+ years. Enrolment: 60.
Status: Authorised, recruitment pending. Decision date: 2025-12-14. Results received: No. Last updated: 2025-12-14.

Condition(s): ST-elevation acute coronary syndrome
Product: Rapibloc 300 mg Pulver zur Herstellung einer Infusionslösung, SODIUM CHLORIDE

Primary endpoint: Proportion of enrolled patients who receive a continuous IV infusion of landiolol for 24 hours with no single interruption > 1 hour.
Endpoint(s): The effect of i.v. administered Landiolol before-, during- and 24h after PCI on the incidence of dysrhythmia (defined as occurrence of ventricular fibrillation, ventricular tachycardia, > 10 extrasystoles per minute, any bradycardia <40/min, any tachycardia >120/min)., Cardiac enzymes (high-sensitive troponin-T, NT-proBNP, CK, CK-MB) and dynamics in electrocardiograms (ECG) at admission, 6 hours, 12, hours, 18 hours, 24 hours and after 90 days, as well as biobanking for future analysis of markers of endothelial function, myocardial function, and inflammation, Unintended and not otherwised-induced (e.g., by administration of morphine or antihypertonic medication) blood pressure decrease of >20% based on the last blood pressure value before Landiolol application, Atrioventricular block (AV-Block II or III) and/or Bradycardia below 45/min within the first 24 hours, Cardiogenic shock (Killip III, IV): Systolic BP (SBP) < 90 mmHg for >30 min, catecholamine support to maintain SBP >90 mmHg, altered mental status, urine output <30 mL/h, cool extremities, Deterioration of heart failure, Suspected Allergic / anaphylactic reaction, Hemodynamic instability defined as a blood pressure drop below 55 mmHg mean arterial pressure (MAP) for longer than 10 minutes (also in combination with the clinical picture – e.g., signs of cardiogenic shock, decompensated heart failure, etc.) within the first 24 hours, Number of re-hospitalizations due to cardiovascular reason within 90 days, Major adverse cardiac and cerebrovascular event (MACE) (Re-infarction (relevant change of 20% in troponin levels between two measurements and recurrence of ST-elevation ≥ 1 mm or new Q-waves in at least two contiguous leads within 28 days of a previous myocardial infarction, need for revascularization) Cardiovascular death/mortality, Early revascularization, Stroke, Heart failure, Stent-thrombosis) combined and separate within first 6 months, All-cause mortality within 6 month, Change of left ventricular ejection fraction (LVEF) in follow-up echocardiography after 90 days from baseline LVEF at admission within 48 hours (evaluated by standardized echocardiography)

Source: https://euclinicaltrials.eu/ctis-public/view/2025-523676-23-00